EU clinical trial 2023-506471-10-00: Phase 3, Single-arm, Open-label, Multidose, Titration, Pharmacokinetic, Pharmacodynamic, and Safety Study of Etelcalcetide in Children and Adolescents ≥ 2 to < 18 Years of age with Secondary Hyperparathyroidism and Chronic Kidney Disease Receiving Maintenance Hemodialysis
Protocol code: 20170724
Sponsor: Amgen Inc. (Pharmaceutical company). Phase: Therapeutic confirmatory (Phase III). Countries: Czechia (ongoing, recruiting), Greece (ongoing, recruiting), Germany (ongoing, recruiting), Italy (ended), Belgium (ended), Poland (ended), Portugal (ongoing, recruiting), Spain (ongoing, recruiting).
Therapeutic area(s): Diseases [C] - Nutritional and Metabolic Diseases [C18]
Gender: Female, Male. Age: 0-17 years. Enrolment: 26.
Start date (EU): 2019-10-04. Decision date: 2024-01-30. Results received: No. Last updated: 2026-06-10.
Decision dates by country: BE: 2024-01-30, IT: 2024-02-14, PL: 2024-02-29, PT: 2024-01-30, CZ: 2024-02-01, DE: 2024-01-31, ES: 2024-03-04, GR: 2024-03-04

Condition(s): Secondary hyperparathyroidism (SHPT) in pediatric patients with chronic kidney disease (CKD) in hemodialysis
Product: Parsabiv 10 mg solution for injection, Parsabiv 5 mg solution for injection

Primary endpoint: Percent change in IPTH from baseline during the efficacy assessment period (EAP) at weeks 20 to 26
Endpoint(s): Achievement of a > 30% reduction from baseline in mean IPTH during the EAP, Percent change from baseline in corrected total serum calcium (Ca) and serum phosphorus from baseline during the EAP, Occurence of corrected serum Ca levels <8.0 mg/dL (2.0 mmol/L) any time during the study, Changes in laboratory parameters, incluidng clinical chemistry, Occurence of hypocalcemia (corrected serum Ca levels <8.4 mg/dL), Etelcalcetide plasma concentrations before and at the end of dialysis after single and multiple doses, Etelcalcetide PK parameters including, but not limited to, maximum plasma concentration ( Cmax) and plasma trough concentrations (Cmin)

Source: https://euclinicaltrials.eu/ctis-public/view/2023-506471-10-00